EU clinical trial 2024-513550-30-00: A Phase 3, Randomized, Double-Blind, Placebo-Controlled Study of Optune® (TTFields, 200 kHz) Concomitant with Maintenance Temozolomide and Pembrolizumab Versus Optune® Concomitant with Maintenance Temozolomide and Placebo for the Treatment of Newly Diagnosed Glioblastoma (EF-41/KEYNOTE D58)
Protocol code: EF-41/KEYNOTE D58
Sponsor: Novocure GmbH (Pharmaceutical company). Phase: Therapeutic confirmatory (Phase III). Countries: Czechia (ongoing, recruitment ended), Italy (ongoing, recruitment ended), Germany (ongoing, recruitment ended), Spain (ongoing, recruiting), France (ongoing, recruitment ended), Poland (ongoing, recruiting).
Therapeutic area(s): Diseases [C] - Neoplasms [C04]
Gender: Female, Male. Age: 18-64 years, 65+ years. Enrolment: 280.
Start date (EU): 2025-03-28. Decision date: 2025-01-27. Results received: No. Last updated: 2026-02-02.
Decision dates by country: PL: 2025-03-02, FR: 2025-02-04, ES: 2025-02-19, CZ: 2025-02-21, DE: 2025-02-26, IT: 2025-01-27

Condition(s): Newly diagnosed Glioblastoma
Product: TEMOZOLOMIDE, KEYTRUDA 25 mg/mL concentrate for solution for infusion, saline solution for infusion

Primary endpoint: OS
Endpoint(s): 1. PFS per RANO 2.0 as assessed by investigator, 2. PFS per RANO as assessed by investigator, 3. PFS6m and PFS12m per RANO 2.0 as assessed by investigator, 4. PFS2 per RANO 2.0 as assessed by investigator, 5. 1- and 2-year survival rates, 6. The EORTC QLQ-C30 with BN20 module score, 7. Subjects experiencing AEs

Source: https://euclinicaltrials.eu/ctis-public/view/2024-513550-30-00